EU clinical trial 2024-515052-20-00: A Global, Randomized, Phase 3, Open-Label Study of REGN2810 (Anti-PD-1 Antibody) versus Platinum-Based Chemotherapy in First-Line Treatment of Patients with Advanced or Metastatic PD-L1 + Non-Small Cell Lung Cancer
Protocol code: R2810-ONC-1624
Sponsor: Regeneron Pharmaceuticals Inc. (Pharmaceutical company). Phase: Therapeutic confirmatory (Phase III). Countries: Czechia (ended), Poland (ended), Greece (ended), Bulgaria (ended).
Therapeutic area(s): Diseases [C] - Neoplasms [C04]
Gender: Female, Male. Age: 18-64 years, 65+ years. Enrolment: 68.
Status: Ended. Start date (EU): 2017-09-20. End date (EU): 2025-04-18. End date: 2025-04-19. Decision date: 2024-09-26. Results received: Yes. Last updated: 2024-12-10.
Decision dates by country: BG: 2024-10-04, CZ: 2024-09-26, GR: 2024-12-10, PL: 2024-09-30

Condition(s): Non-small Cell Lung Cancer
Product: LIBTAYO 350 mg concentrate for solution for infusion., Armisarte 25 mg/ml concentrate for solution for infusion, Gemcitabine 2 g Powder for Solution for Infusion, Paclitaxel 6 mg/ml Concentrate for Solution for Infusion, Carboplatin 10 mg/ml concentrate for solution for infusion, Cisplatin 1 mg/ml Concentrate for Solution for Infusion

Primary endpoint: Overall survival (OS), Progression-free survival (PFS) as assessed by a blinded Independent review committee (IRC) using RECIST 1.1
Endpoint(s): Objective response rates (ORR), Best overall response (BOR), Compare the duration of response (DOR) of cemiplimab versus platinum based chemotherapies, Change from baseline in quality of life (QoL) scores as assessed by the European Organization for the Research and Treatment of Cancer Quality of Life Questionnaire Core 30 (EORTC QLQ-C30), Change from baseline in in lung cancer symptom scores as measured by the EORTC Lung Cancer 13 (EORTC QLQ-LC13), Incidence of Adverse Events (AEs), Incidence of serious adverse events (SAEs), Incidence of deaths, Incidence of laboratory abnormalities, Measure concentrations of cemiplimab in serum, Characterize the pharmacokinetics (PK) of cemiplimab

Source: https://euclinicaltrials.eu/ctis-public/view/2024-515052-20-00